EU clinical trial 2024-512680-31-00: Long term safety follow up of patients enrolled in the phase I/II clinical trial of haematopoietic stem cell gene therapy for the Wiskott-Aldrich Syndrome (GTG002-07 and GTG003-08)
Protocol code: GNT-WAS-03
Sponsor: Genethon (Laboratory/Research/Testing facility). Phase: Therapeutic exploratory (Phase II). Countries: France (ongoing, recruiting).
Therapeutic area(s): Diseases [C] - Hemic and Lymphatic Diseases [C15]
Gender: Male. Age: 0-17 years, 18-64 years. Enrolment: 5.
Status: Ongoing, recruiting. Start date (EU): 2014-10-29. Decision date: 2024-07-25. Results received: No. Last updated: 2025-09-25.

Condition(s): Treatment of Wiskott-Aldrich Syndrome
Product: Autologous CD34+cells transduced with the w1.6_hWASP_WPRE (VSVg) lentiviral vector

Primary endpoint: To evaluate the incidence and type of SAEs and more specifically the incidence and nature of delayed events such as malignancies, hematologic, autoimmune events, mortality continuously over the 13 years duration of the post gene therapy follow up study., To evaluate the safety of the gene therapy procedure for gene transfer analysis at yearly post gene therapy visits: lentiviral integration sites in different cell subpopulation, quantification of VCN (vector copy numbers) on sorted cell population by real time by q-PCR. At 11, 12, 13, 14 and 15 years post gene therapy time points, lentiviral integration sites will be assessed only in case of AESI occurrence., To evaluate the safety of the gene therapy procedure for replication competent lentivirus (RCL) at yearly post gene therapy visits. At 11, 12, 13, 14 and 15 years post gene therapy time points, RCL will be assessed only in case of AESI occurrence., To evaluate the clinical status of patients at 3, 4, 5, 6, 7, 8, 9 and 10 years post gene therapy visits: weight, and complete clinical exam ., To evaluate the evolution of the key medical events related to the WAS at 3, 4, 5, 6, 7, 8, 9 and 10 years post gene therapy visits: eczema status, infections, bleeding symptoms, autoimmune manifestations., To evaluate the haematological reconstitution of the patient at 3, 4, 5, 6, 7, 8, 9 and 10 years post gene therapy visits: CBC including platelet count and size., To evaluate the reconstitution of cell mediated and humoral immunity of the patient: o at 3, 4, 5, 6, 7, 8, 9 and 10 years post gene therapy visits: immunophenotyping panel (Lymphocytes subset including Wasp protein expression), restoration of antibody production (IgA, IgM, IgG, IgE), whole blood lymphocytes proliferation assays, humoral response to antigen (CD3 stimulation). o at 3, 4 and 5 years post gene therapy visits: humoral response to antigen (PHA, candida).
Endpoint(s): To evaluate the evolution of the need for associated treatments at yearly post gene therapy visits (Immunoglobulins, antibacterial, antifungal and antiviral drugs, transfusions)., To evaluate the representation of TCR families by PCR, TREC (TCR excision circle) and TCR V beta panel at 3, 4 and 5 years post gene therapy., To evaluate the bone marrow integrity at 3, 4 and 5 years post gene therapy by performing a bone marrow aspiration (optional).

Source: https://euclinicaltrials.eu/ctis-public/view/2024-512680-31-00